EU clinical trial 2024-516503-17-01: Tandem therapy LutaPol/ltraPol ( I 77Lu / 90Y-DOTATATE) as an effective method in the treatment of neuroendocrine neoplasmas.
Protocol code: DuoNen2020
Sponsor: Narodowe Centrum Badan Jadrowych (Laboratory/Research/Testing facility). Phase: Therapeutic confirmatory (Phase III). Countries: Poland (authorised, recruitment pending).
Therapeutic area(s): Diseases [C] - Neoplasms [C04]
Gender: Female, Male. Age: 18-64 years, 65+ years. Enrolment: 92.
Status: Authorised, recruitment pending. Decision date: 2025-01-11. Results received: No. Last updated: 2026-03-27.

Condition(s): Diagnosed and histopathologically confirmed diffuse or locally unresectable, well and intermediate differentiated neuroendocrine tumour of the gastrointestinal tract
Product: DuoNEN solution for injection

Primary endpoint: Disease progression assessed by CT or MRI according to RECIST 1.1. Timepoints of Primary End Point evaluation: control imaging investigations (CT or MRI) using the technique identical with the one based on which the patient was qualified for the trial, performed after 3,6,12,24,36,49,60 months after completion of therapy with assessment according to RECIST 1.1
Endpoint(s): Assessment of effectiveness and safety of personalized therapy. It is planned to perform biochemical tests during visit W1, during hospitalization and in the course of observation every 3 months (tests of blood morphology, urea, creatinine, eGFR, bilirubin). Total volume of blood collected at single timepoint - 6.8 ml.

Source: https://euclinicaltrials.eu/ctis-public/view/2024-516503-17-01